EU clinical trial 2023-505494-32-00: A Randomized, Multicenter, Double-blind, Parallel, Active-control Study of the Effects of Sparsentan, a Dual Endothelin Receptor and Angiotensin Receptor Blocker, on Renal Outcomes in Patients with Primary Focal Segmental Glomerulosclerosis (FSGS)
Protocol code: 021FSGS16010
Sponsor: Travere Therapeutics Inc. (Pharmaceutical company). Phase: Therapeutic confirmatory (Phase III). Countries: Germany (ended), Belgium (ended), France (ended), Spain (ended), Czechia (ended), Croatia (ended), Denmark (ended), Sweden (ended), Portugal (ended), Estonia (ended), Poland (ended), Italy (ended).
Therapeutic area(s): Diseases [C] - Pathological Conditions, Signs and Symptoms [C23]
Gender: Female, Male. Age: 0-17 years, 18-64 years, 65+ years. Enrolment: 116.
Status: Ended. Start date (EU): 2018-10-15. End date (EU): 2026-02-24. End date: 2026-03-19. Decision date: 2024-09-24. Results received: No. Last updated: 2026-03-10.
Decision dates by country: CZ: 2024-09-25, DK: 2024-09-27, EE: 2024-09-27, FR: 2024-09-25, DE: 2024-09-26, PT: 2024-09-27, PL: 2024-11-07, BE: 2024-09-25, HR: 2024-09-25, SE: 2024-09-24, IT: 2024-10-28, ES: 2024-09-25

Condition(s): Focal segmental glomerulosclerosis (FSGS)
Product: Sparsentan_DF2, IRBESARTAN, Sparsentan_DF3

Primary endpoint: Efficacy End points: The primary efficacy endpoint is the slope of eGFR over approximately 2 years of randomized treatment assessed at the final analysis. The surrogate efficacy endpoint is the proportion of patients achieving a target reduction in proteinuria., Safety End points: Descriptive statistics will be used to summarize the safety data., Open-Label Endpoints: Endpoints for the open-label extension include, but are not necessarily limited to : The absolute and percent change from Week 112 in eGFR at each visit, Open-Label Endpoints: The percent change from Week 112 in UP/C at each visit, Open-Label Endpoints: Changes from Week 112 in QOL at each visit, Open-Label Endpoints: Changes from Week 112 in body weight, vital signs, physical examinations, peripheral edema, and clinical laboratory parameters, Open-Label Endpoints: Changes from Week 112 in lipid profile (total cholesterol and triglycerides, LDL-C, and HDL C, Open-Label Endpoints: The incidence of TEAEs during the open-label extension
Endpoint(s): Secondary Efficacy Endpoints: The secondary efficacy endpoints in non-US countries are: • The percent change from Week 6 in eGFR at Week 108 • The percent change in eGFR from baseline of the double-blind period to 4 weeks post -cessation of randomized treatment at Week 112 • The slope of eGFR following the initiation of randomized treatment

Source: https://euclinicaltrials.eu/ctis-public/view/2023-505494-32-00